EU clinical trial 2024-512117-40-00: Prospective analysis of the therapeutic efficacy of iron isomaltoside in combination with or without dopaminergic therapy in patients with restless legs syndrome
Protocol code: IDRLS
Sponsor: Medizinische Universitaet Innsbruck (Educational Institution). Phase: Therapeutic confirmatory (Phase III). Countries: Austria (authorised, recruitment pending).
Therapeutic area(s): Not possible to specify
Gender: Female, Male. Age: 18-64 years, 65+ years. Enrolment: 140.
Status: Authorised, recruitment pending. Decision date: 2024-10-14. Results received: No. Last updated: 2026-06-29.

Condition(s): restless leg syndrome
Product: Kochsalz ”Braun” 0,9% - Infusionslösung, MonoFer 100 mg/ml Lösung zur Injektion/Infusion

Primary endpoint: Changes in RLS severity as detected by the IRLS
Endpoint(s): Changes in RLS severity as detected by the sIRLS, RLS-6 and CGI, Changes in blood count, iron, Tf, TSAT, ferritin, sTfR, hepcidin-25, creatinine (GFR), GPT, GOT, LDH, CRP, electrolytes (Na, K, P, Ca), PTH, LCN2, dopamine, 1,25-(OH)2 vitamin D, 25-OH vitamin D, EPO, ERFE, PDGF-BB, LCN2 and metabolites (ATP, NADH/NAD, Lactate, Succinate, Citrate, Pyruvate, free fatty acids), Changes in mitochondrial iron and Krebs cycle metabolism gene expression in monocytes detected by RT-PCR, Changes in mitochondrial respiration of selected and randomly assigned patients measured with OROBOROS respirometry, Changes in iron content in the substantia nigra detected by an MRI in a subgroup of 80 patients (20 dopaminergic therapy/iron, 20 dopaminergic therapy/placebo, 20 no previous treatment/iron and 20 no previous treatment/placebo)

Source: https://euclinicaltrials.eu/ctis-public/view/2024-512117-40-00